EU clinical trial 2024-515259-40-00: Contrast-enhanced ultrasound for sentinel node detection in patients with melanoma, breast cancer or head & neck cancer (N24CUS)
Sponsor: Het Nederlands Kanker Instituut-Antoni van Leeuwenhoek Ziekenhuis Stichting (Hospital/Clinic/Other health care facility). Phase: Phase II and Phase III (Integrated). Countries: Netherlands (ongoing, recruiting).
Therapeutic area(s): Analytical,Diagnostic,Therapeutic Techniques and Equipment [E]-Surgical Procedures, Operative [E04]; Diseases [C] - Neoplasms [C04]
Gender: Female, Male. Age: 18-64 years, 65+ years. Enrolment: 91.
Status: Ongoing, recruiting. Start date (EU): 2025-07-07. Decision date: 2024-12-09. Results received: No. Last updated: 2024-12-09.

Condition(s): breast cancer, melanoma, head & neck cancer
Product: Sonazoid 8 mikroliter per ml pulver og væske til injeksjonsvæske, dispersjon

Primary endpoint: sensitivity and specificity of the CEUS SN localization method
Endpoint(s): time required to localize the SNs using CEUS in minutes, usability of the CEUS system using a system-usability-score (SUS), sensitivity and specificity of using CEUS to predict if SNs are malignant

Source: https://euclinicaltrials.eu/ctis-public/view/2024-515259-40-00